EU clinical trial 2023-505940-20-00: The Optimised use of Romosozumab Study
Sponsor: Aarhus University Hospital (Hospital/Clinic/Other health care facility). Phase: Phase III and phase IV (Integrated). Countries: Denmark (ongoing, recruiting).
Therapeutic area(s): Diseases [C] - Musculoskeletal Diseases [C05]
Gender: Female. Age: 18-64 years, 65+ years. Enrolment: 270.
Status: Ongoing, recruiting. Start date (EU): 2023-09-26. Decision date: 2023-08-10. Results received: No. Last updated: 2026-06-11.

Condition(s): osteoporosis
Product: Aclasta 5 mg solution for infusion, EVENITY 105 mg solution for injection in pre-filled syringe

Primary endpoint: Change in total hip BMD at 24 months
Endpoint(s): Change in lumbar spine and femoral neck BMD at 24 months, Change in HRpQCT derived bone microarchitecture at 24 months, Changes in bone turnover markers during the course of the trial, Bone modelling and remodelling assessed by histomorphometry of bone biopsies, Increase in number and composition of osteoprogenitor cells in the bone marrow, Effect of romosozumab on glucose metabolism and interaction with changes in bone turnover markers and BMD

Source: https://euclinicaltrials.eu/ctis-public/view/2023-505940-20-00